EU clinical trial 2023-506165-62-00: Optimization of atopic dermatitis treatment that requires second-line systemic therapy through multiomic predictive models of treatment response (DermAtOmics-II)
Protocol code: DermAtOmics-II
Sponsor: Hospital Universitario La Paz (Hospital/Clinic/Other health care facility). Phase: Therapeutic use (Phase IV). Countries: Spain (ongoing, recruiting).
Therapeutic area(s): Diseases [C] - Skin and Connective Tissue Diseases [C17]
Gender: Female, Male. Age: 0-17 years, 18-64 years, 65+ years. Enrolment: 0.
Status: Ongoing, recruiting. Start date (EU): 2023-09-25. Decision date: 2023-08-01. Results received: No. Last updated: 2025-08-20.

Condition(s): Atopic dermatitis
Product: Cibinqo 200 mg film-coated tablets, Olumiant 4 mg film-coated tablets, Dupixent 300 mg solution for injection in pre-filled syringe, RINVOQ 15 mg prolonged-release tablets, Adtralza 150 mg solution for injection in pre-filled syringe

Primary endpoint: Percentage of patients with primary non-response to second-line treatment. Defined as fail to achieve EASI-75 (a 75% improvement in EASI score) at week 16 of follow-up.
Endpoint(s): Percentage of patients achieving EASI-75 at week 6 of follow-up., Percentage of patients reaching 90 percentage (EASI-90) improvement from baseline during follow-up., Time to treatment failure with cyclosporine defined as EASI ≤ 50 during follow-up after week 16., Mean percentage of change in EASI score from baseline to week 16., Percentage of change in SCORAD from baseline to the primary endpoint (week 16)., Percentage of patients experiencing an improvement of at least 75% in SCORAD from the baseline value., Reduction of IGA (investigator global assessment) at week 16., Time to IGA score of 0/1 (clear or almost clear)., Change of BSA (Body surface area) involment at week 16, Change in NRS (numerical rating scale) at week 16, Change in RECAP at week 16., Percentage of patients having a variation of 4 points in their improvement in DLQI (Dermatology Life Quality Index)., Change in POEM (Patient Oriented Eccema Measure) and DLQI (Dermatology Life Quality Index) at week 16., Change in the score of the different scales in the different follow-up visits compared to baseline visit., Rate of adverse events associated to treatment.

Source: https://euclinicaltrials.eu/ctis-public/view/2023-506165-62-00